EU clinical trial 2024-516623-14-00: ATA129-EBV-205 An Open-label, Single-arm, Multicohort, Phase 2 Study to Assess the Efficacy and Safety of Tabelecleucel in Subjects with Epstein-Barr Virus-associated Diseases (EBVision)
Protocol code: ATA129-EBV-205
Sponsor: Pierre Fabre Medicament (Pharmaceutical company). Phase: Therapeutic exploratory (Phase II). Countries: Spain (ongoing, recruiting), Belgium (ongoing, recruiting), Austria (ongoing, recruiting), Italy (ongoing, recruiting), France (ongoing, recruiting).
Therapeutic area(s): Diseases [C] - Immune System Diseases [C20]
Gender: Female, Male. Age: 0-17 years, 18-64 years, 65+ years. Enrolment: 64.
Status: Ongoing, recruiting. Start date (EU): 2021-03-17. Decision date: 2024-10-02. Results received: No. Last updated: 2026-02-16.
Decision dates by country: BE: 2024-10-02, IT: 2024-10-14, AT: 2024-10-07, FR: 2024-10-10, ES: 2024-10-03

Condition(s): EBV+ primary imunodeficiency lymphoproliferative disease (LPD), EBV+ post-transplant LPD where standard first line therapy (rituximab or chemotherapy) is inappropriate, including CD20-negative disease, EBV+ sarcomas, including leiomyosarcoma, or smooth muscle tumors, EBV+ associated post-transplant LPD involving the central nervous system (EBV+ CNS PTLD)
Product: EBVALLO

Primary endpoint: The ORR obtained following administration of tabelecleucel with up to different human leukocyte antigen (HLA) restrictions
Endpoint(s): Overall survival (OS), Duration of response (DOR), Progression-free survival (PFS), For EBV-associated lymphoproliferative disease in the setting of primary imunodeficiency (EBV+ PID LPD) cohort: Number of participants who reach definitive therapy (i.e., allogeneic HCT) for the underlying disease. Time to definitive therapy., For EBV+ sarcoma cohort, including leiomyosarcoma (LMS), or smooth muscle tumors: Clinical benefit rate. ORR by immune response evaluation criteria in solid tumors (iRECIST) criteria [Seymour 2017]

Source: https://euclinicaltrials.eu/ctis-public/view/2024-516623-14-00